EU clinical trial 2023-506599-28-01: Pulse corticosteroids or/and Immunoglobulins to treat fulminant Myocarditis: a double-blind randomized controlled adaptive trial (The CORIUM study)
Protocol code: APHP220808
Sponsor: Assistance Publique Hopitaux De Paris (Hospital/Clinic/Other health care facility). Phase: Therapeutic exploratory (Phase II). Countries: France (authorised, recruitment pending).
Therapeutic area(s): Diseases [C] - Cardiovascular Diseases [C14]
Gender: Female, Male. Age: 18-64 years, 65+ years. Enrolment: 120.
Status: Authorised, recruitment pending. Decision date: 2025-01-09. Results received: No. Last updated: 2025-01-09.

Condition(s): Fulminant myocarditis
Product: METHYLPREDNISOLONE, METHYLPREDNISOLONE, IMMUNOGLOBULINS, NORMAL HUMAN, FOR INTRAVASCULAR ADM., GLUCOSE 5 % B.BRAUN, solution pour perfusion

Primary endpoint: - A hierarchical composite outcome assessed at day 28 of mortality or heart transplantation/VAD/persisting t-MCS and the number of days alive without t-MCS and inotropes within the 28 days following randomization
Endpoint(s): Mortality at day 28/60/90, - VAD or/and heart transplant at day 28/60/90, - Number of t-MCS-free days at day 28, - Number of inotropes-free days at day 28, - Time to improvement in left ventricular function assessed by echocardiography at D3/D7/D14/D28 following randomization, - Time to normalize troponin and N-terminal pro–B-type natriuretic peptide within 14 days after randomization, - Incidence of drugs side effects (nosocomial infections, significant gastrointestinal bleeding, renal insufficiency, acute delirium leading to the use of neuroleptic agents), - Proportion of patients with left ventricular ejection fraction (LVEF) < 55% and/or left ventricular dilatation at 28-day, - Proportion of patients with at least one episode of ventricular arrhythmia at day-28, - Proportion of patients with at least one episode of atrioventricular block (degree II and III) or sinoatrial, atrioventricular or intraventricular block, - The proportion of patients with LVEF<55%, left ventricular dilatation, and late gadolinium enhancement at 6 months evaluated by cardiac magnetic resonance imaging

Source: https://euclinicaltrials.eu/ctis-public/view/2023-506599-28-01